EU clinical trial 2025-521142-22-00: A Phase 3 Trial to Evaluate the Long-Term Safety and Efficacy of Navenibart in Participants with Hereditary Angioedema – ORBIT-EXPANSE
Protocol code: STAR-0215-302
Sponsor: Astria Therapeutics Inc. (Pharmaceutical company). Phase: Therapeutic confirmatory (Phase III). Countries: Netherlands (ongoing, recruiting), Spain (ongoing, recruiting), Poland (ongoing, recruiting), Germany (ongoing, recruiting), Czechia (ongoing, recruiting), Austria (authorised, recruitment pending), Portugal (authorised, recruitment pending), Hungary (authorised, recruitment pending), France (ongoing, recruiting), Italy (authorised, recruiting), Bulgaria (ongoing, recruiting).
Therapeutic area(s): Diseases [C] - Congenital, Hereditary, and Neonatal Diseases and Abnormalities [C16]
Gender: Female, Male. Age: 0-17 years, 18-64 years, 65+ years. Enrolment: 53.
Start date (EU): 2026-03-27. Decision date: 2026-02-09. Results received: No. Last updated: 2026-07-20.
Decision dates by country: HU: 2026-02-16, IT: 2026-02-12, ES: 2026-02-12, DE: 2026-02-09, PL: 2026-02-16, NL: 2026-02-12, FR: 2026-02-13, AT: 2026-02-09, PT: 2026-02-10, BG: 2026-02-16, CZ: 2026-02-10

Condition(s): Hereditary Angioedema
Product: Navenibart, Navenibart - matching placebo

Primary endpoint: Incidence of treatment-emergent adverse events
Endpoint(s): Number of time-normalized investigator-confirmed HAE attacks, Number of moderate or severe investigator-confirmed HAE attacks, Number of investigator-confirmed HAE attacks that require on-demand treatment, Percent reduction in monthly investigator-confirmed HAE attacks, Time to first investigator-confirmed HAE attack after first dose, The number of participants responding to treatment, defined as a ≥ 50%, ≥ 70%, or ≥ 90% reduction in investigator-confirmed HAE attack rate, Number of participants with no investigator-confirmed HAE attacks, Angioedema Quality of Life (AE-QoL) questionnaire total score

Source: https://euclinicaltrials.eu/ctis-public/view/2025-521142-22-00